EU clinical trial 2022-501547-33-01: Single-blind, investigator-initiated, randomized, controlled trial to assess the safety and efficacy of intravenous corticosteroid therapy to treat patients with acute myocarditis with mildly reduced left ventricular ejection fraction
Protocol code: MYTHSMR2023-07
Sponsor: Antwerp University Hospital (Hospital/Clinic/Other health care facility). Phase: Phase III and phase IV (Integrated). Countries: Belgium (ongoing, recruiting), Italy (ongoing, recruiting), Slovenia (ongoing, recruiting), Spain (ongoing, recruiting).
Therapeutic area(s): Diseases [C] - Cardiovascular Diseases [C14]
Gender: Female, Male. Age: 18-64 years. Enrolment: 205.
Status: Ongoing, recruiting. Start date (EU): 2024-12-24. Decision date: 2024-02-06. Results received: No. Last updated: 2026-03-06.
Decision dates by country: ES: 2024-06-21, BE: 2024-02-06, IT: 2024-04-11, SI: 2024-04-23

Condition(s): Acute myocarditis
Product: SODIUM CHLORIDE, Solu-Medrone 125 mg

Primary endpoint: The primary objective is to demonstrate an increase in the rate of the primary composite endpoint (LVEF >55% or increase of 10%) in patients treated with pulsed corticosteroid therapy vs. standard therapy and maximal supportive care.
Endpoint(s): The main secondary composite endpoint is defined as the reduction in the proportion of patients with LVEF<55% AND/OR LV dilation on 6-month cardiac magnetic resonance imaging (CMRI) (CMRI clips will be centrally reviewed in a blind fashion by readers), Proportion of patients with LV dilation on 6-months CMRI, Proportion of patients with LVEF<55% on 6-month CMRI, LGE burden (% of mass) on 6 month CMRI, Composite endpoint defined as the time from randomization to the first event ((1) all-cause death or (2) HTx or (3) long-term LVAD implantation, or (5) first rehospitalization due to HF or ventricular arrhythmias, or advanced AV block) occurring within 6 months and 2 years, Mortality: Time from randomization to all-cause death within 6 months and 2 years, Time from randomization tot hospitalization for heart failure within 6 months and 2 years, Composite endpoint of presence of NSVT OR burden of PVC`s>10% on 24 hour ECG ambulatory monitoring, performed at 6 months follow-up, Burden of PVCs (% of total heart beats) on 24 hour holtermonitoring, performed at 6 months follow-up, Presence of NSVT on 24 hour holtermonitoring performed at 6 months follow-up, Quality of life and health assessment at 2 and 6 months follow-up using the EuroQol 5-dimension, 5 level questionnaire, Recurrence of acute myocarditis at six months and 2 years, Hospitalization due to recurrence of AM, pericarditis or recurrence of chest pain or atrial fibrillation, In-hospital composite endpoint, defined as the proportion of patients who experience at least one of the following events during index hospitalization: 1. all-cause death, or 2. Htx, or 3. long-term LVAD implant, or 4. need for an upgrading of the t-MCS, or 5. a VT/VF treated with DC shock (excluding VT/VF in patients on t-MCS other than IABP., relative reduction of troponin levels after 5 days from randomization, Reduction in heart rate on ECG after 3 days from randomization, increase in LVEF on echocardiogram after 5 days from randomization, Number of days in the hospital, number of days on the ICU, Need for inotropes, number of days on t-MCS

Source: https://euclinicaltrials.eu/ctis-public/view/2022-501547-33-01